EU clinical trial 2024-512753-24-00: HOVON 173 AML: Ivosidenib and Azacitidine With or Without Venetoclax in Adult Patients With Newly Diagnosed IDH1-Mutated AML or MDS/AML Considered Ineligible for Intensive Chemotherapy
Protocol code: HOVON 173 AML
Sponsor: Hemato-Oncologie voor Volwassenen Nederland (Hovon) Stichting (Hospital/Clinic/Other health care facility). Phase: Therapeutic confirmatory (Phase III). Countries: Austria (authorised, recruitment pending), Netherlands (ongoing, recruiting), Finland (ongoing, recruiting), France (ongoing, recruiting), Belgium (ongoing, recruiting), Sweden (ongoing, recruiting), Germany (ongoing, recruiting), Denmark (authorised, recruiting), Estonia (authorised, recruiting), Ireland (authorised, recruiting), Italy (authorised, recruitment pending), Lithuania (authorised, recruiting), Norway (authorised, recruiting), Spain (ongoing, recruiting).
Therapeutic area(s): Diseases [C] - Neoplasms [C04]
Gender: Female, Male. Age: 18-64 years, 65+ years. Enrolment: 180.
Start date (EU): 2025-08-05. Decision date: 2025-04-16. Results received: No. Last updated: 2026-08-07.
Decision dates by country: IE: 2025-09-08, EE: 2025-09-05, NO: 2025-09-04, ES: 2025-08-08, LT: 2025-09-04, NL: 2025-04-17, DE: 2025-04-16, FR: 2025-04-22, FI: 2025-04-16, AT: 2025-04-22, SE: 2025-04-16, IT: 2025-09-11, BE: 2025-04-17, DK: 2025-10-13

Condition(s): Acute Myeloid Leukemia (AML)
Product: Venclyxto 50 mg film-coated tablets, Venclyxto 10 mg film-coated tablets, AG-120/S95031 250mg film-coated tablet, placebo to match venetoclax 10 mg, placebo to match venetoclax 100 mg, Venclyxto 100 mg film-coated tablets, placebo to match venetoclax 50 mg, AZACITIDINE

Primary endpoint: EFS in patients with newly diagnosed IDH1-mutated AML, measured from the date of randomization to the date of treatment failure, hematologic relapse from CR/CRh or death from any cause, whichever occurs first. Treatment failure is defined as lack of obtaining either CR or CRh by week 24
Endpoint(s): 1. OS in patients with newly diagnosed IDH1-mutated AML measured from the date of randomization to the date of death from any cause., 2. Rate of CR/CRh in patients with newly diagnosed IDH1-mutated AML, defined as the proportion of AML patients with CR/CRh at any time-point during on treatment period., 3. Rate of CR in patients with newly diagnosed IDH1-mutated AML defned as the proportion of AML patients with CR at any time-point during protocol treatment, 4. Rate of CR/CRi in patients with newly diagnosed IDH1-mutated AML, defined as the proportion of AML patients with CR/CRi at any time point during protocol treatment., 5. Rates of CR, CR/CRh, and CR/CRi without measurable residual disease (CRMRD-, CR/CRhMRD-, and CR/CRiMRD-) in patients with newly diagnosed IDH1-mutated AML, defined as the proportion of AML patients with CRMRD- / CR/CRhMRD- / CR/CRiMRD- at any time point during protocol treatment., 6. Time to achievement of response (CR, CR/CRh, and CR/CRi) in patients with newly diagnosed IDH1-mutated AML, defined as the time from randomization to 1st occurrence of response., 7. Duration of response (CR, CR/CRh, and CR/CRi) in patients with newly diagnosed IDH1-mutated AML, measured from the date of achievement of a response until the date of hematologic relapse or death from any cause., 8. Rate of transfusion independence (platelets and RBC) in patients with newly diagnosed IDH1-mutated AML, defined as the proportion of AML patients who achieved transfusion independence., 9. Ivosidenib and venetoclax plasma concentrations, 10. Quality of life in patients with newly diagnosed IDH1-mutated AML as assessed by EORTC QLC-C30 and EQ-5D-5L forms., 11. CIR in adult patients with newly diagnosed IDH1-mutated AML, measured from the date of achievement of a remission (CR/CRh) until the date of hematologic relapse (i.e. not molecular relapse); death without relapse considered as competing risk, 12. CID in patients with newly diagnosed IDH1-mutated AML, measured from the date of achievement of a remission (CR/CRh) to death without prior relapse; patients not known to have died will be censored at the date of last contact; relapse is considered as competing risk, 13. EFS, OS, DoR and rates of CR, CR/CRh and CR/CRi across different subgroups in patients with newly diagnosed IDH1-mutated AML, where the groups are defined based on prognostic characteristics including clinical variables (e.g., age at randomization, sex, ECOG performance status, white blood cell count), risk category according to 2022 ELN recommendations, as well as specific AML genotypes., 14. EFS, OS, rates of CR, CR/CRh, CR/CRi, CRMRD-, CR/CRhMRD-, CR/CRiMRD-, time to response, DoR, CIR, CID in patients with newly diagnosed IDH1-mutated MDS/AML., 15. Transfusion independence rate and safety endpoints as defined below in patients with newly diagnosed IDH1-mutated MDS/AML., 16. 2-HG-plasmaconcentraties, 17. Frequency and severity of AE according to CTCAE version 5.0 in patients with newly diagnosed IDH1-mutated AML., 18. Time to hematopoietic recovery (absolute neutrophil counts ≥0.5 and ≥1.0 x 109/L; platelets ≥50 and ≥100 x 109/L) after each treatment cycle (but at least for each of the first 6 cycles) in patients with newly diagnosed IDH1-mutated AML, defined as the time from the start of the cycle until recovery., 19. Number of patients requiring transfusion (platelet and RBC) and number of units transfused, length of hospital stay, in patients with newly diagnosed IDH1-mutated AML.

Source: https://euclinicaltrials.eu/ctis-public/view/2024-512753-24-00